EU clinical trial 2024-518150-17-00
Protocol code: CLI-10196AA1-01
Sponsor: Chiesi Farmaceutici S.p.A. (Pharmaceutical company). Phase: Human Pharmacology (Phase I)- Other. Countries: Belgium (ended).
Therapeutic area(s): Diseases [C] - Respiratory Tract Diseases [C08]
Gender: Female, Male. Age: 18-64 years. Enrolment: 40.
Status: Ended. Start date (EU): 2025-03-10. End date (EU): 2025-08-13. Decision date: 2025-01-15. Results received: No. Last updated: 2025-03-11.

Condition(s): Non-cystic fibrosis bronchiectasis

Source: https://euclinicaltrials.eu/ctis-public/view/2024-518150-17-00